EU clinical trial 2023-508221-27-02: Study of excretion of CORTICOSTEROIDS to improve their detection in Anti-doping controls.
Sponsor: Parc De Salut Mar (Hospital/Clinic/Other health care facility). Phase: Human Pharmacology (Phase I)- Other. Countries: Spain (ended).
Therapeutic area(s): Analytical, Diagnostic and Therapeutic Techniques and Equipment [E] - Therapeutics [E02]
Gender: Female, Male. Age: 18-64 years. Enrolment: 44.
Status: Ended. Start date (EU): 2024-04-19. End date (EU): 2026-03-12. Decision date: 2024-03-20. Results received: No. Last updated: 2025-08-21.

Condition(s): Healthy volunteers

Source: https://euclinicaltrials.eu/ctis-public/view/2023-508221-27-02